EU clinical trial 2024-515678-29-00: A phase II study to assess the efficacy of the anti-PD-L1 antibody atezolizumab (MPDL3280A) administered with stereotactic ablative radiotherapy (SABR) in patients with metastatic tumours (SABR-PDL1)
Protocol code: 2015/2335
Sponsor: Institut Gustave Roussy (Hospital/Clinic/Other health care facility). Phase: Therapeutic exploratory (Phase II). Countries: France (ended).
Therapeutic area(s): Diseases [C] - Neoplasms [C04]
Gender: Female, Male. Age: 18-64 years, 65+ years. Enrolment: 111.
Status: Ended. Start date (EU): 2016-11-15. End date (EU): 2026-06-29. Decision date: 2024-10-25. Results received: No. Last updated: 2024-10-25.

Condition(s): Patients with metastatic tumours (colorectal, non-small cell lung, renal and sarcoma)
Product: ATEZOLIZUMAB

Primary endpoint: One year-Progression-free survival rate is defined as the rate of patients alive and free of progression at one year. Progression is defined using RECIST 1.1. criteria, or death, whatever the cause of death, whichever occurs first
Endpoint(s): Efficacy: Progression-free survival (PFS) measured from the date of treatment initiation to date of progression or death whichever comes first. Patients alive and free of progression at the cut-off date will be censored at the last assessment date Tumour response indicators and clinical endpoints, assessed according to RECIST v 1.1 and modified RECIST (see synopsis), Toxicity : NCI- CTCAE V4.03 scale Toxicity is adverse events graded with the NCI-CTC-AE v4.03 scale, at least possibly related to the treatment., For patients with lung cancer and sarcoma receiving a second SABR course for oligoprogression(see synopsis)

Source: https://euclinicaltrials.eu/ctis-public/view/2024-515678-29-00